EU clinical trial 2024-518578-15-00: CLArithromycin versus AZIthromycin in the treatment of Mycobacterium avium complex pulmonary infections: A randomized prospective controlled study (CLAZI)
Protocol code: PI2017_843_0010
Sponsor: Centre Hospitalier Universitaire Amiens Picardie (Hospital/Clinic/Other health care facility). Phase: Therapeutic confirmatory (Phase III). Countries: France (ongoing, recruiting).
Therapeutic area(s): Diseases [C] - Bacterial Infections and Mycoses [C01]
Gender: Female, Male. Age: 18-64 years, 65+ years. Enrolment: 424.
Status: Ongoing, recruiting. Start date (EU): 2018-02-05. Decision date: 2024-10-30. Results received: No. Last updated: 2026-01-23.

Condition(s): Is to demonstrate a non inferior efficacy of azithromycin and so the possibility for clinician to choose between two drugs for Mycobacterium avium complex treatment.
Product: RIFADINE 300 mg, gélule, CLARITHROMYCINE ARROW 500 mg, comprimé pelliculé à libération modifiée, DEXAMBUTOL 500 mg, comprimé pelliculé, AZITHROMYCINE TEVA 250 mg, comprimé pelliculé

Primary endpoint: The primary endpoint is the 6-month negative sputum conversion rate.
Endpoint(s): For safety: digestive toxicity (WHO criteria and Rhodes scale (28, 29)), for hepatitis (cytolysis higher than 3 times normal rate), Clinical improvement on analogic scales, Radiological improvement on CT scan criteria (dimensions of the lesions compared to the baseline CT, classified as complete resolution of the lesions, partial resolution of the lesions: reduction of at least 50% of the lesions, stabilization: size of the lesion between 50% and 130% compared to baseline, deterioration of lesions: appearance of new lesions or greater than 30%, 3 and 12 months sputum conversion (Culture results of respiratory specimens taken 3 and 12 months after starting treatment), 12 months outcome (death), 1 month and 6 months peak serum and mononuclear cells concentration of azithromycin and clarithromycin and their main metabolites (D-azithromycin and 14-OH clarithromycin respectively) determined by liquid chromatography-tandem mass spectrometry (LC-MS/MS), MAC species and 6-month conversion

Source: https://euclinicaltrials.eu/ctis-public/view/2024-518578-15-00